EU clinical trial 2022-502408-57-00: PEACE-6 Poor Responders: A randomized phase III trial evaluating the efficacy and safety of 177Lu-PSMA-617 in addition to Standard of Care (SoC) versus SoC alone in de novo metastatic hormone-sensitive prostate cancer (mHSPC) patients having a serum PSA level of ≥ 0.2 ng/mL at 6 to 8 months after systemic treatment initiation for mHSPC.
Protocol code: UC-GTG-2301
Sponsor: Unicancer (Hospital/Clinic/Other health care facility). Phase: Therapeutic confirmatory (Phase III). Countries: France (ongoing, recruiting), Belgium (authorised, recruitment pending), Ireland (authorised, recruitment pending), Italy (authorised, recruitment pending), Spain (authorised, recruitment pending), Netherlands (authorised, recruitment pending).
Therapeutic area(s): Diseases [C] - Neoplasms [C04]; Diseases [C] - Male Urogenital Diseases [C12]
Gender: Male. Age: 18-64 years, 65+ years. Enrolment: 420.
Start date (EU): 2024-09-04. Decision date: 2024-03-29. Results received: No. Last updated: 2026-05-22.
Decision dates by country: FR: 2024-03-29, BE: 2026-05-08, IE: 2026-05-22, IT: 2026-04-30, ES: 2026-05-20, NL: 2026-05-11

Condition(s): Novo metastatic hormone-sensitive prostate cancer (mHSPC) patients having a serum PSA level of ≥ 0.2 ng/mL at 6 to 8 months after systemic treatment initiation for mHSPC (i.e. poor responders) in the absence of evidence of cancer progression (including a rising PSA level)
Product: ABIRATERONE ACETATE, DAROLUTAMIDE, Locametz 25 micrograms kit for radiopharmaceutical preparation, APALUTAMIDE, Pluvicto 1 000 MBq/mL solution for injection/infusion, ENZALUTAMIDE

Primary endpoint: Overall Survival (OS) is defined as the time from the date of randomization to the date of death due to any cause. Patients still alive at time of the analysis will be censored at the date of last news., Radiographic Progression-free survival (rPFS) is defined as the time from randomization to the date of radiographic progression according to PCWG3 criteria by investigator assessment, or death, whichever occurs first. In absence of radiographic progression or death, the data will be censored at the date of the last PCWG3 radiographic assessment.
Endpoint(s): Efficacy_Castration-Resistance Prostate Cancer-Free Survival (CRPC-FS) is defined as the time from randomization to the onset of castration-resistant prostate cancer or death from any cause, whichever occurs first. In absence of castration-resistance or death, the data will be censored at the date of the last PCWG3 assessment (minimum date PSA/imaging)., Efficacy_Prostate cancer-specific survival (PCSS) is defined as the time from the date of randomization to the date of death due to prostate cancer. Death due to another cause than prostate cancer will be censored at the date of death. Patients still alive at time of the analysis will be censored at the date of last news., Efficacy_PSA response will be assessed by the maximum change of PSA (rise or fall) from baseline over the treatment period. A complete PSA response is defined by an undetectable level of serum PSA., Efficacy_Skeletal-related event-free survival (SRE-FS) is defined as the time from the randomization date to the date of diagnosis of either an SRE (fracture, or a bone pain requiring radiation therapy, or a spinal cord compression, or a preventive surgery to the bones) or death, whichever occurs first. Events will be evaluated by the investigators. No systematic X-Ray will be performed. In absence of SRE or death, data will be censored at the date of last news., Efficacy_Time to severe urinary event (SUE) is defined as the time from the randomization date to the date of diagnosis of either one of the following SUE, whichever occurs first: urinary retention with need for a urinary catheter, suprapubic catheter, double J stent, nephrostomy, treatment of the prostate by radiotherapy or trans-urethral resection of the prostate or prostatectomy done to relieve patients with local symptoms. In absence of SUE, data will be censored at the date of last news., Efficacy_Time to initiation of subsequent(first and second)anti-cancer systemic therapy for CRPC(TTSST1 and TTSST2).TTSST1 is defined as the time from randomization date to the date of initiation of first anti-cancer systemic therapy for CRPC.TTSST2 is defined as the time from the randomization date to the date of initiation of the second anti-cancer systemic therapy for CRPC. In absence of initiation of a subsequent anti-cancer systemic therapy, data will be censored at the date of last news, Efficacy of subsequent (first and second) anti-cancer systemic therapy for CRPC will be assessed by either PSA response or rPFS, or OS and will be defined as the time from first and second anti-cancer systemic therapy for CRPC to disease progression or death from any cause, whichever comes first., Efficacy_Quality of Life (QoL) will be evaluated using the Brief Pain Inventory-Short Form (BPI-SF) and the Functional Assessment of Cancer Therapy-Prostate (FACT-P) questionnaire., Safety_Toxicity will be evaluated according to NCI-CTCAE v5.0., Exploratory_Biomarkers assessment to identify molecular characteristics and genetic or phenotypic abnormalities to correlate with disease outcome., Exploratory_Early PSMA PET evaluation and correlation between PSA and PSMA uptake variation will be assessed at 3 months (after cycle 2) according to PROMISE 2.0 criteria. In case of progression detected at early PSMA PET scan, it would not be considered for stopping treatment., Exploratory_Identification of PSMA PET imaging biomarkers to predict response and disease outcome will be assessed at pre-randomization based on semiquantitative analysis and total tumoral volume expressing PSMA., Exploratory_Radiation dosimetry of tumor tissues and normal organs (notably in salivary gland, bone marrow and kidney) to predict response and toxicity respectively will be perfomed on post-therapeutic images performed after the first cycle of 177Lu PSMA-617 (at least at 4 hours for output patients or 4 hours and 24 hours and Day 5 in case of hospitalization)._

Source: https://euclinicaltrials.eu/ctis-public/view/2022-502408-57-00